EU clinical trial 2022-502977-41-00: A Global, Phase 3, Randomized, Multicenter, Open-Label Study to Investigate the Efficacy and Safety of Furmonertinib Compared to Platinum-Based Chemotherapy as First-Line Treatment for Patients with Locally Advanced or Metastatic Non-Small Cell Lung Cancer with Epidermal Growth Factor Receptor Exon 20 Insertion Mutations (FURVENT)
Protocol code: FURMO-004
Sponsor: Arrivent Biopharma Inc. (Pharmaceutical company). Phase: Therapeutic confirmatory (Phase III). Countries: Spain (ongoing, recruitment ended), France (ongoing, recruitment ended), Italy (ongoing, recruitment ended), Netherlands (ongoing, recruitment ended).
Therapeutic area(s): Diseases [C] - Neoplasms [C04]
Gender: Female, Male. Age: 18-64 years, 65+ years. Enrolment: 70.
Status: Ongoing, recruitment ended. Start date (EU): 2023-06-23. Decision date: 2023-09-11. Results received: No. Last updated: 2026-05-11.
Decision dates by country: ES: 2023-09-04, NL: 2023-09-19, FR: 2024-08-02, IT: 2023-09-26

Condition(s): Non-Small Cell Lung Cancer
Product: Pemetrexed Pfizer 500 mg powder for concentrate for solution for infusion, Pemetrexed Fresenius Kabi 25 mg/ml concentrate for solution for infusion, Cisplatin Hikma 1 mg/ml Konzentrat zur Herstellung einer Infusionslösung, Furmonertinib, Cisplatin NeoCorp 1 mg/ml - Konzentrat zur Herstellung einer Infusionslösung, Carboplatin Bendalis 10mg/ml, Konzentrat zur Herstellung einer Infusionslösung, Carboplatin Hikma 10 mg/ml Konzentrat zur Herstellung einer Infusionslösung, Pemetrexed Fresenius Kabi 25 mg/ml concentrate for solution for infusion, Carboplatine Fresenius Kabi 10 mg/ml concentraat voor oplossing voor infusie , Pemetrexed Fresenius Kabi 25 mg/ml concentrate for solution for infusion, Pemetrexed Accord 500 mg powder for concentrate for solution for infusion., Cisplatin Accord 1 mg/ml Konzentrat zur Herstellung einer Infusionslösung

Primary endpoint: PFS, where PFS is defined as the time from randomization to the first occurrence of disease progression, as determined by BICR using RECIST v1.1, or death from any cause, whichever occurs first
Endpoint(s): • OS, defined as the time from randomization to death from any cause., • PFS as determined by investigator assessment using RECIST v1.1., •Objective response rate (ORR), defined as the percentage of patients with a complete response (CR) or partial response (PR) relative to the total number of patients by BICR and investigator assessment using RECIST v1.1. For full list of secondary endpoints, please refer to protocol.

Source: https://euclinicaltrials.eu/ctis-public/view/2022-502977-41-00